EU clinical trial 2025-522333-61-00: A randomized, double-blind, placebo-controlled, dose-ranging Phase 2 study of brivekimig followed by a maintenance period in participants with moderate to severe hidradenitis suppurativa
Protocol code: DRI19220
Sponsor: Sanofi-Aventis Recherche & Developpement (Pharmaceutical company). Phase: Therapeutic exploratory (Phase II). Countries: Poland (ongoing, recruiting), Hungary (ongoing, recruiting), Netherlands (ongoing, recruiting), Germany (ongoing, recruiting), Czechia (ongoing, recruiting), Spain (ongoing, recruiting), France (ongoing, recruiting), Italy (ongoing, recruiting), Greece (ongoing, recruiting).
Therapeutic area(s): Diseases [C] - Immune System Diseases [C20]
Gender: Female, Male. Age: 18-64 years, 65+ years. Enrolment: 132.
Status: Ongoing, recruiting. Start date (EU): 2026-02-24. Decision date: 2025-12-22. Results received: No. Last updated: 2026-07-23.
Decision dates by country: ES: 2026-01-09, PL: 2026-01-04, DE: 2025-12-23, CZ: 2026-01-08, FR: 2025-12-22, NL: 2025-12-31, GR: 2026-02-26, IT: 2025-12-23, HU: 2026-01-07

Condition(s): Hidradenitis suppurativa

Primary endpoint: Percentage of participants achieving Hidradenitis Suppurativa Clinical Response 75 (HiSCR75)
Endpoint(s): Percentage of participants achieving Hidradenitis Suppurativa Clinical Response 50 (HiSCR50), Percentage of participants achieving Hidradenitis Suppurativa Clinical Response 90 (HiSCR90), Change from Baseline in draining tunnel count at Week 16., Change from Baseline in International Hidradenitis Suppurativa Severity Score System (IHS4) at Week 16, Percentage of participants achieving response on the Hidradenitis Suppurativa Skin Pain Numeric Rating Scale from the HS Symptom Assessment Questionnaire (HS-SAQ skin pain NRS) at week 8, Change from Baseline in Hidradenitis Suppurativa Quality of Life (HiSQOL) total score at Week 16., Change from Baseline in Dermatology Life Quality Index (DLQI) total score at Week 16., Number of participants with treatment-emergent adverse events (TEAE), serious adverse events (SAE) and laboratory anomalies., Serum brivekimig concentration throughout the study, Incidence of treatment-emergent (TE) anti-drug antibody responses.

Source: https://euclinicaltrials.eu/ctis-public/view/2025-522333-61-00